EU clinical trial 2024-519875-24-00: A Randomized, Parallel Group, Placebo-Controlled Study to Evaluate the Efficacy and Safety of Paltusotine in Adults with Carcinoid Syndrome due to Well-Differentiated Neuroendocrine Tumors (CAREFNDR)
Protocol code: CRN00808-12
Sponsor: Crinetics Pharmaceuticals Inc. (Pharmaceutical company). Phase: Therapeutic confirmatory (Phase III). Countries: France (ongoing, recruiting), Italy (authorised, recruiting), Spain (ongoing, recruiting), Poland (authorised, recruiting), Belgium (authorised, recruitment pending), Germany (authorised, recruiting), Ireland (authorised, recruitment pending), Denmark (not authorised), Sweden (not authorised), Romania (authorised, recruiting).
Therapeutic area(s): Diseases [C] - Neoplasms [C04]
Gender: Female, Male. Age: 18-64 years, 65+ years. Enrolment: 97.
Start date (EU): 2025-09-26. Decision date: 2025-07-28. Results received: No. Last updated: 2026-07-20.
Decision dates by country: RO: 2025-11-17, DE: 2025-10-30, ES: 2025-07-31, IT: 2025-07-30, FR: 2025-07-28, BE: 2025-11-14, IE: 2025-11-14, PL: 2025-08-04

Condition(s): Carcinoid syndrome
Product: Placebo, Paltusotine 40 mg tablets, Paltusotine 40 mg tablets

Primary endpoint: Treatment group difference of change from baseline to Week 12 in flushing episodes/day averaged over the 14 days prior to Week 12.
Endpoint(s): Key Secondary: Treatment group difference of change from baseline to Week 12 in BMs/day averaged over the 14 days.

Source: https://euclinicaltrials.eu/ctis-public/view/2024-519875-24-00